EU clinical trial 2025-521368-37-00: Adjunctive Hyperbaric Oxygen Treatment for Patients with Necrotizing Soft-Tissue Infection (HOT-NSTI trial)
Sponsor: Rigshospitalet (Hospital/Clinic/Other health care facility). Phase: Therapeutic use (Phase IV). Countries: Sweden (authorised, recruitment pending), Finland (authorised, recruitment pending), Belgium (ongoing, recruiting), Norway (authorised, recruitment pending), Denmark (authorised, recruitment pending).
Therapeutic area(s): Diseases [C] - Bacterial Infections and Mycoses [C01]
Gender: Female, Male. Age: 18-64 years, 65+ years. Enrolment: 980.
Start date (EU): 2026-03-27. Decision date: 2025-06-30. Results received: No. Last updated: 2026-06-29.
Decision dates by country: DK: 2025-06-30, FI: 2025-06-30, SE: 2025-06-30, BE: 2025-07-01, NO: 2025-07-01

Condition(s): Necrotizing soft-tissue infection
Product: Medical Liquid Oxygen

Primary endpoint: 30-day all-cause mortality post-randomization
Endpoint(s): 90-day all-cause mortality post-randomization, Amputation (y/n) within 7 days post-randomization, Quality of life at Day 90 evaluated with the 5Q-5D-5L, Quality of life at Day 90 evaluated with the WHO-DAS questionnaire, Days alive and out of hospital in the 90-day period, Ventilator-free days within 7 days post-randomization, Need for renal-replacement therapy (y/n) within 7 days, Number of subjects with one or more serious adverse events up to 24 hours after last treatment

Source: https://euclinicaltrials.eu/ctis-public/view/2025-521368-37-00